EU clinical trial 2024-511633-35-00: Consolidation with ADCT-402 (loncastuximab tesirine) after a short course of immunochemotherapy: a phase II study in BTKi-treated (or BTKi intolerant) Relapsed/Refractory (R/R) Mantle Cell Lymphoma (MCL) patients
Protocol code: FIL_COLUMN
Sponsor: Fondazione Italiana Linfomi Ets (Patient organisation/association). Phase: Therapeutic exploratory (Phase II). Countries: Italy (ongoing, recruitment ended).
Therapeutic area(s): Diseases [C] - Hemic and Lymphatic Diseases [C15]
Gender: Female, Male. Age: 18-64 years, 65+ years. Enrolment: 49.
Status: Ongoing, recruitment ended. Start date (EU): 2022-03-21. Decision date: 2024-08-07. Results received: No. Last updated: 2024-09-30.

Condition(s): Mantle cell lymphoma
Product: CYTARABINE, LONCASTUXIMAB TESIRINE, RITUXIMAB, BENDAMUSTINE

Primary endpoint: 12-month Progression-Free Survival (PFS), defined as the time between the date of enrollment and the first documentation of recurrence, progression or death from any cause; responding patients and patients who are lost to follow up will be censored at their last assessment date. PFS will be assessed on an ITT (Intention to Treat) basis.
Endpoint(s): Overall survival (OS), defined as the time between the start of treatment until death from any cause; patients who are lost at follow up will be censored at their last assessment date. Analysis will be on an ITT basis., Rate of conversion from partial response to complete response (PR to CR) and from stable disease (SD) to PR/CR rate, assessed by comparing responses prior to and after loncastuximab tesirine., Overall Response Rate (ORR), CR, PR and SD rate, will be defined according to Lugano 2014 criteria. The best overall response will be defined as the best response between the date of beginning of therapy and the last restaging. Patients without response assessment (due to whatever reason) will be considered as non-responders., Duration of Response (DOR), defined as the time from the first documentation of tumor response (CR/PR) to disease progression or death according to Lugano 2014 criteria. Analysis will be on an ITT basis, Event-Free Survival (EFS), defined as the time from start of treatment to disease progression, death, or discontinuation of treatment for any reason (e.g. toxicity, patient preference), or initiation of a new treatment without documented progression. Analysis will be on an ITT basis., MRD negativity rate, defined as the rate of MRD (Minimal Residual Disease) negativity after induction treatment (2 x R-BAC), at the end of consolidation with the loncastuximab tesirine and after 6 and 12 months after the end of consolidation., Rate of Adverse Events Any grade III or higher toxicities will be recorded and classified according to the definitions of the current version of the NCI Common Terminology Criteria for Adverse Events (CTCAE). Toxicity events will be determined by the incidence of severe, life-threatening (CTCAE grade 3, 4 and 5) and/or serious adverse events (SAEs) commencing after the first induction dose or at any time during therapy.

Source: https://euclinicaltrials.eu/ctis-public/view/2024-511633-35-00